EU clinical trial 2024-517024-20-00: Multicentric randomized phase I / II study to evaluate efficacy of trifluridine/tipiracil +/- bevacizumab plus XB2001 (anti-IL-1α True Human antibody) versus trifluridine/tipiracil +/- bevacizumab plus placebo in metastatic colorectal cancer patients after failure of oxaliplatin, irinotecan, fluoropyrimidine
Protocol code: TASKIN
Sponsor: Centr Georges Francois Leclerc (Hospital/Clinic/Other health care facility). Phase: Phase I and Phase II (Integrated)- Other. Countries: France (ongoing, recruitment ended).
Therapeutic area(s): Diseases [C] - Digestive System Diseases [C06]
Gender: Female, Male. Age: 18-64 years, 65+ years. Enrolment: 190.
Status: Ongoing, recruitment ended. Start date (EU): 2022-09-27. Decision date: 2024-11-22. Results received: No. Last updated: 2025-05-16.

Condition(s): Metastatic colorectal cancer patients

Source: https://euclinicaltrials.eu/ctis-public/view/2024-517024-20-00